EU clinical trial 2022-500383-35-00: Vitamin-K-Antagonist and direct thrombin inhibitor Dabigatran for thrombus resolution in left ventricular thrombus after acute STEMI: an open label randomized controlled multicenter Phase-II study
Sponsor: Medical University Of Graz (Educational Institution). Phase: Therapeutic exploratory (Phase II). Countries: Austria (ended).
Therapeutic area(s): Diseases [C] - Cardiovascular Diseases [C14]
Gender: Female, Male. Age: 18-64 years, 65+ years. Enrolment: 116.
Status: Ended. Start date (EU): 2024-06-04. End date (EU): 2026-03-31. Decision date: 2024-05-31. Results received: No. Last updated: 2024-05-31.

Condition(s): STEMI (ST elevation myocardial infarction), Left ventricular thrombosis
Product: CLOPIDOGREL, ACETYLSALICYLIC ACID, Pradaxa 110 mg hard capsules, MARCOUMAR - Tabletten, Pradaxa 150 mg hard capsules

Primary endpoint: It is defined a binary composite primary endpoint consisting of incomplete thrombus resolution after three months of treatment and the 3-month incidence of a new symptomatic (clinical ischemic stroke) or asymptomatic (“silent” brain infraction detected by screening MRI) brain infarction.
Endpoint(s): Prevalence of complete thrombus resolution after 3 months of anticoagulant treatment with dabigatran or phenprocoumon., Cumulative 3-month incidence of symptomatic or asymptomatic brain infarction., Cumulative 12-month incidence of symptomatic or asymptomatic brain infarction., Cumulative incidence of bleeding events using the BARC 2,3,5 bleeding criteria during active study (3 months) and 1 year follow up .

Source: https://euclinicaltrials.eu/ctis-public/view/2022-500383-35-00